EU clinical trial 2023-508155-40-00: Phase II investigational study of pembrolizumab combination with chemotherapy in platinum-sensitive recurrent low-grade serous ovarian cancer
Protocol code: NOGGO-ov44
Sponsor: Nord-Ostdeutsche Gesellschaft Fuer Gynaekologische Onkologie e.V. (Laboratory/Research/Testing facility). Phase: Therapeutic exploratory (Phase II). Countries: Germany (ongoing, recruitment ended).
Therapeutic area(s): Diseases [C] - Neoplasms [C04]
Gender: Female. Age: 18-64 years, 65+ years. Enrolment: 33.
Status: Ongoing, recruitment ended. Start date (EU): 2022-01-25. Decision date: 2024-02-02. Results received: No. Last updated: 2026-04-10.

Condition(s): recurrent platin sensitive low-grade serous ovarian-, fallopian tube- and/or primary peritoneal cancer
Product: KEYTRUDA 25 mg/mL concentrate for solution for infusion

Primary endpoint: 12-month (48 weeks) progression free survival (PFS) rate
Endpoint(s): ORR, OS and PFS rate after 6, 12, 18 and 24 months, PFS and OS as time-to-event variables, Response rate (SD, PR or CR) after 6, 12, 18 and 24 months, Ki-67 expression <3.6% versus ≥3.6% and response rate and PFS, Safety Endpoints – safety of combination therapy (ctx and pembrolizumab) CTCAE v5.0 will be used as endpoint, Time of subsequent medical intervention, TFST and response (CR, PR, SD, PD) to first subsequent treatment, QoL (EORTC-QLQ-C30, EORTC-QLQ-OV-28) until 6 months after progress

Source: https://euclinicaltrials.eu/ctis-public/view/2023-508155-40-00